EU clinical trial 2023-509860-47-00: Multimodal Imaging with FAPI-PET/MRI in Breast Carcinoma-In-Situ for Detection of occult Invasive cancer (MI-CISDIR)
Protocol code: WWU22_0012
Sponsor: Universitaet Muenster (Educational Institution). Phase: Therapeutic exploratory (Phase II). Countries: Germany (ongoing, recruiting).
Therapeutic area(s): Diseases [C] - Neoplasms [C04]
Gender: Female, Male. Age: 18-64 years, 65+ years. Enrolment: 30.
Status: Ongoing, recruiting. Start date (EU): 2026-02-20. Decision date: 2024-04-25. Results received: No. Last updated: 2026-05-05.

Condition(s): Ductal carcinoma in situ, Breast cancer
Product: Gadovist® 1,0 mmol/ml Injektionslösung, [68Ga]FAPI-46

Primary endpoint: Sensitivity based on blinded readers‘ PET/MRI visual assessment score, Specificity based on blinded readers‘ PET/MRI visual assessment score
Endpoint(s): Optimal threshold and area-under-the-curve of receiver-operating- characteristics curve based on tumor-to-background ratio of SUVmax (60-75min), Diagnostic Odds Ratio (DOR) based on Blinded readers’ PET/MRI vs MRI only visual assessment score, Sensitivity and specificity of lesion MRI diffusion weighted MRI apparent diffusion coefficient (ADC), Sensitivity and specificity of the DCE-MRI dynamic feature “Maximal Slope”, Sensitivity and specificity of the DCE-MRI dynamic feature “Bolus arrival time”, Sensitivity and specificity of the DCE-MRI pharmacokinetic modeling parameter: Volume transfer constant (KTrans), Sensitivity and specificity of the DCE-MRI pharmacokinetic modeling parameter: Fractional plasma volume (Vp), Sensitivity and specificity of static PET SUVmax (60-75min), Sensitivity and specificity of dynamic PET pharmacokinetic modeling parameter binding potential (BP), Number of additional biopsies triggered by PET/MRI visual assessment, Number of additional biopsies triggered by MRI visual assessment, Correlation of immunohistopathology FAP visual staining Score with SUVmax (60-75min), Adverse events following [68Ga]Ga-FAPI-46 application

Source: https://euclinicaltrials.eu/ctis-public/view/2023-509860-47-00